EU clinical trial 2025-523117-28-00: A Phase 2, multicenter, open label, non-randomized study to evaluate the efficacy and safety of extended dosing of belantamab mafodotin in different combinations with standard of care regimens in participants with relapsed-refractory multiple myeloma (DREAMM-15)
Protocol code: 224317
Sponsor: Glaxosmithkline Research & Development Limited (Pharmaceutical company). Phase: Therapeutic exploratory (Phase II). Countries: France (ongoing, recruiting), Germany (ongoing, recruiting), Greece (ongoing, recruiting), Netherlands (ongoing, recruiting), Spain (ongoing, recruiting).
Therapeutic area(s): Diseases [C] - Neoplasms [C04]
Gender: Female, Male. Age: 18-64 years, 65+ years. Enrolment: 45.
Status: Ongoing, recruiting. Start date (EU): 2026-06-12. Decision date: 2026-04-13. Results received: No. Last updated: 2026-06-10.
Decision dates by country: FR: 2026-04-14, DE: 2026-04-13, ES: 2026-04-15, NL: 2026-04-13, GR: 2026-04-15

Condition(s): Relapsed or Refractory Multiple Myeloma
Product: POMALIDOMIDE, DEXAMETHASONE, POMALIDOMIDE, POMALIDOMIDE, BORTEZOMIB, CARFILZOMIB, CARFILZOMIB, CARFILZOMIB, DEXAMETHASONE, POMALIDOMIDE

Primary endpoint: ORR, defined as the percentage of participants with a confirmed PR or better (i.e., PR, VGPR, CR, sCR).
Endpoint(s): • CRR, defined as the percentage of participants with a confirmed CR or better. • MRD negativity rate, defined as the percentage of participants who achieve MRD negative status at least once during the time of confirmed CR or better response as per IMWG. • DoR, defined as the time from first documented evidence of PR or better until PD or death due to any cause., • Incidence and severity of AEs and SAEs; • Incidence of AEs leading to dose modifications or study intervention discontinuation; • Incidence and severity of ocular findings on ophthalmic exam (changes in VA and cornea findings)., OSDI, PRO-CTCAE (ocular), PROSIM-Q, and CTCAEs (eye disorders – other) concordance with KVA

Source: https://euclinicaltrials.eu/ctis-public/view/2025-523117-28-00